EU clinical trial 2022-502008-62-00: The Growth Hormone Deficiency Reversal Trial: Effect on final height of discontinuation vs continuation of growth hormone treatment in pubertal children with isolated growth hormone deficiency – A non-inferiority randomised controlled trial
Protocol code: NIHR127468
Sponsor: University College London (Educational Institution). Phase: Therapeutic confirmatory (Phase III). Countries: Austria (ended).
Therapeutic area(s): Diseases [C] - Hormonal diseases [C19]
Gender: Female, Male. Age: 0-17 years. Enrolment: 40.
Status: Ended. Start date (EU): 2023-05-17. End date (EU): 2024-12-04. Decision date: 2023-03-20. Results received: Yes. Last updated: 2023-03-20.

Condition(s): Growth Hormone Deficiency (GHD)
Product: NutropinAq 10 mg/2 ml (30 IU) solution for injection., Saizen 8 mg/ml Injektionslösung in einer Patrone, Omnitrope 5 mg/1.5 ml solution for injection in cartridge, HUMATROPE 6 mg - Pulver und Lösungsmittel zur Herstellung einer Injektionslösung, Norditropin FlexPro 15 mg/1,5 ml Injektionslösung in einem Fertigpen, Genotropin® MiniQuick 0,2 mg - Pulver und Lösungsmittel zur Herstellung einer Injektionslösung

Primary endpoint: Final Height in Standard Deviation Score (FH SDS)
Endpoint(s): Growth Related: The proportion of children reaching normal adult height (- 2SD) The proportion reaching mid-parental Target Height (- 2SD) Difference in child's Target Height minus Final Height (in Standard Deviation Score and centimetres) Bone Related: Bone age delay at Final Height Bone age acceleration between enrolment and Final Height Bone health index at Final Height Biochemistry: Serum IGF-1 and lipid profiles (fasting lipids - serum triglyceride and total serum cholesterol) at Final Heig

Source: https://euclinicaltrials.eu/ctis-public/view/2022-502008-62-00